EU clinical trial 2024-518339-12-00: A Randomized Double-Blind Study to Evaluate the Efficacy and Safety of CAL101 in Patients with Idiopathic Pulmonary Fibrosis
Protocol code: CAL101-201
Sponsor: Calluna Pharma AS (Pharmaceutical company). Phase: Therapeutic exploratory (Phase II). Countries: Spain (ongoing, recruitment ended), Norway (ongoing, recruitment ended), Netherlands (ongoing, recruitment ended), Denmark (ongoing, recruitment ended), Romania (ongoing, recruitment ended), France (ongoing, recruitment ended), Italy (ongoing, recruitment ended).
Therapeutic area(s): Diseases [C] - Respiratory Tract Diseases [C08]
Gender: Female, Male. Age: 18-64 years, 65+ years. Enrolment: 87.
Status: Ongoing, recruitment ended. Start date (EU): 2025-07-08. Decision date: 2025-06-24. Results received: No. Last updated: 2026-08-03.
Decision dates by country: NO: 2025-06-25, DK: 2025-06-25, FR: 2025-06-24, IT: 2025-06-25, NL: 2025-06-24, RO: 2025-06-24, ES: 2025-06-27

Condition(s): Idiopathic Pulmonary Fibrosis
Product: SODIUM CHLORIDE

Primary endpoint: Absolute change from baseline in FVC (mL) through 28 weeks (repeated measures) confirmed by central read of FVC.
Endpoint(s): Percentage of patients with adverse events (AEs) through 40 weeks., Change from baseline in % predicted FVC through 28 weeks (repeated measures) confirmed by central reading of FVC. For additional secondary end points pls refer to the Protocol.

Source: https://euclinicaltrials.eu/ctis-public/view/2024-518339-12-00